EU clinical trial 2024-518611-18-00: Phase II “proof of concept” Study, randomized 1:1, to evaluate whether dapagliflozin reduces chemotherapy induced cardiotoxicity in participants with breast cancer treated with (neo-) adjuvant Anthracycline-based chemotherapy +/- trastuzumab, study is national multicentered
Sponsor: Fondazione IRCCS Policlinico San Matteo (Hospital/Clinic/Other health care facility). Phase: Therapeutic exploratory (Phase II). Countries: Italy (ongoing, recruitment ended).
Therapeutic area(s): Diseases [C] - Cardiovascular Diseases [C14]
Gender: Female, Male. Age: 18-64 years, 65+ years. Enrolment: 316.
Status: Ongoing, recruitment ended. Start date (EU): 2024-12-03. Decision date: 2024-12-03. Results received: No. Last updated: 2025-12-17.

Condition(s): Chemotherapy-induced cardiotoxicity in breast cancer
Product: Forxiga 10 mg film-coated tablets

Primary endpoint: to assess whether the administration of dapagliflozin is associated with a lower rate of asymptomatic and symptomatic CTRCD during 18 months during a 18 months follow-up
Endpoint(s): to assess whether the administration of dapagliflozin is associated with a lower rate of asymptomatic CTRCD during 18 months

Source: https://euclinicaltrials.eu/ctis-public/view/2024-518611-18-00